EU clinical trial 2025-524206-15-00: A research study looking into how cagrilintide influences food intake and appetite in people with overweight or obesity
Protocol code: NN9833-8421
Sponsor: Novo Nordisk A/S (Pharmaceutical company). Phase: Human Pharmacology (Phase I)- Other. Countries: Germany (ongoing, recruiting).
Therapeutic area(s): Diseases [C] - Nutritional and Metabolic Diseases [C18]
Gender: Female, Male. Age: 18-64 years. Enrolment: 120.
Status: Ongoing, recruiting. Start date (EU): 2026-04-24. Decision date: 2026-04-02. Results received: No. Last updated: 2026-04-23.
Decision dates by country: DE: 2026-04-23

Condition(s): Obesity

Source: https://euclinicaltrials.eu/ctis-public/view/2025-524206-15-00